EU clinical trial 2024-513808-34-00: A randomized crossover clinical trial regarding the blockage of the mineralocorticoid receptor using Eplerenone on the evolution of arterial stiffness in kidney patients one year after transplant: EVATRAN (The effect of Eplerenone on the evolution of Vasculopathy in renal transplant patients).
Protocol code: CPRC2018/EVATRAN
Sponsor: CHRU De Nancy (Hospital/Clinic/Other health care facility). Phase: Therapeutic confirmatory (Phase III). Countries: France (ended).
Therapeutic area(s): Diseases [C] - Cardiovascular Diseases [C14]
Gender: Female, Male. Age: 18-64 years, 65+ years. Enrolment: 36.
Status: Ended. Start date (EU): 2021-10-12. End date (EU): 2025-10-14. Decision date: 2024-08-07. Results received: No. Last updated: 2025-08-06.

Condition(s): kidney transplantation
Product: INSPRA 25 mg, comprimé pelliculé

Primary endpoint: Evolution of pulse wave velocity (PWV in m/s) adjusted to the blood pressure measured by Sphygmocor®, after 6 months of treatment with eplerenone
Endpoint(s): Evolution after 6 months of treatment of central Systolic Blood Pressure (CSPc), Central Diastolic Blood Pressure (CDAb), Central Pulsed Pressure (CPp), Index of Increase (Aix in %), measured by Sphygmocor® (Atcor medical) applanation tonometry, Evolution after six months of treatment of Peripheral systolic blood pressure (PASp in mmHg), peripheral diastolic blood pressure (PADp in mmHg), peripheral pulse pressure (PPp in mmHg), Evolution after six months of treatment of intima-media thickness (in mm) measured by Echotracking (ART.LAB, ESAOTE®), Evolution after six months of treatment of left ventricular mass (LVM in g/m2) measured by cardiac ultrasound, Evolution after 6 months of treatment of biological markers of oxidative stress (plasma Isoprostane and Malondialdehyde (MDA)), Evolution after 6 months of treatment of biological markers of endothelial dysfunction (endothelin, soluble endothelium selectin (sE-selectin), von Willebrand factor ), Graft function measured by blood creatinine (in micromol/L) with estimation of glomerular filtration rate (DFGe in mL/min/1.73m2 ) according to the CKD-EPI formula as well asproteinuria measured by the ratio proteinuria/creatininuria (in mg/g). The percentage of patients with DFG ≥ 90, 60-89, 45-59, 30-44, 15-29, <15ml/min/1.73m2 will also be evaluated, as well as the percentage of patients with ratio proteinuria/creatininuria <500; 500-1000, 1000-2000, 2000-3000, >3000 at 6 months, Occurrence of hyperkalemia ≥ 5.5 mmol/L and the number of hyperkalemias during hyperkalemia follow-up between 5 - 5.49; 5.5 - 6; >6mmol/L, Risk of acute renal failure defined as an increase in creatinine of more than 50%.

Source: https://euclinicaltrials.eu/ctis-public/view/2024-513808-34-00